EU clinical trial 2024-515589-15-00: Controlled and randomized clinical trial to evaluate the efficacy of the combination of oxytocin plus Self-Compassion Training (SCT) in patients with Borderline Personality Disorder (BPD).
Protocol code: IIBSP-OXI-2022-124
Sponsor: Fundacio Institut De Recerca De L'Hospital De La Santa Creu I Sant Pau (Hospital/Clinic/Other health care facility). Phase: Therapeutic use (Phase IV). Countries: Spain (ongoing, recruiting).
Therapeutic area(s): Psychiatry and Psychology [F] - Psychological Phenomena [F02]
Gender: Female, Male. Age: 18-64 years. Enrolment: 80.
Status: Ongoing, recruiting. Start date (EU): 2024-07-25. Decision date: 2024-07-24. Results received: No. Last updated: 2025-02-26.

Condition(s): Borderline Personality Disorder.
Product: Denominación Común Internacional (DCI): placebo (Suero fisiológico) Denominación Química: Cloruro Sódico 0.9%; Forma molecular: NaCl; Composición cuali y cuantitativa: 9mg/ml; Forma farmacéutica: solución para pulverización nasal Dosis y vía de administración: 0.6ml/ día (6 pulverizaciones ) vía intranasa, Syntocinon 40 U.I./ml Solução para pulverização nasal

Primary endpoint: Self-compassion/self-invalidation measures: Self Compassion Scale Short Form (SCS-SF; Neff, 2003; García-Campayo et al., 2014).
Endpoint(s): Self-criticism/self-aggression and self-reassurance scale-short form (FSCRS-SF; Gilbert et al., 2004, Navarrete et al. 2021)., Symptomatology characteristic of Borderline Personality Disorder (BPD) through the Borderline Symptoms List-23 (BSL23; Bohus et al., 2009; Soler et al., 2013)., Rage symptomatology through lSTAXI (Miguel-Tobal et al., 2001)., Satisfaction with life: Satisfaction with life scale (SWLS; Diener et al., 1985; Atienza et al., 2000)., Additional measures of well-being: Pemberton Happiness Index (PHI; Hervás et al., 2013)., Measures of functionality: WHO Quality of Life Scale WHOQOL-BREF (WHOQOL-Group, 1998).

Source: https://euclinicaltrials.eu/ctis-public/view/2024-515589-15-00